EU clinical trial 2023-510079-74-00: Efficacy of ultrasound-monitored meniscal wall betamethasone infiltration on pain in relation to degenerative meniscal injury: a randomized, double-blind, placebo-controlled multicenter trial. MINUS (Meniscal INfiltration of corticosteroid guided with Ultra Sonography)
Protocol code: RC31/23/0387
Sponsor: Centre Hospitalier Universitaire De Toulouse (Hospital/Clinic/Other health care facility). Phase: Therapeutic confirmatory (Phase III). Countries: France (ongoing, recruiting).
Therapeutic area(s): Analytical, Diagnostic and Therapeutic Techniques and Equipment [E] - Anesthesia and Analgesia [E03]; Diseases [C] - Musculoskeletal Diseases [C05]
Gender: Female, Male. Age: 18-64 years, 65+ years. Enrolment: 152.
Status: Ongoing, recruiting. Start date (EU): 2025-03-06. Decision date: 2024-07-19. Results received: No. Last updated: 2025-08-13.

Condition(s): meniscal pain of degenerative origin
Product: Sodium Chloride Injection BP 0.9% w/v, CHLORHYDRATE DE LIDOCAINE RENAUDIN 10 mg/ml, solution injectable, DIPROSTENE, suspension injectable en seringue pré-remplie

Primary endpoint: The primary endpoint is the change in meniscal pain measured using the Visual Analog Scale (VAS) between the initial visit and the 1-month follow-up visit
Endpoint(s): the evolution of the VAS score between the initial visit and the 3-month follow-up visit, the evolution of the score of each dimension (Pain, Symptoms, Activities of daily living, Sport and recreation function, and Knee-related qualities of life) of the algo-functional scale KOOS (appendix 1) between the initial visit and the 1-month follow-up visit, the evolution of each dimension of the algo-functional scale KOOS score between the initial visit and the 3-month follow-up visit, the occurrence of adverse events (AEs) and serious AEs (SAEs) up to 3 months of follow-up, Analgesic response is defined as a at least 50% reduction in pain (measured using the VAS scale) between the initial visit and the 1-month follow-up visit.

Source: https://euclinicaltrials.eu/ctis-public/view/2023-510079-74-00